EU clinical trial 2024-511168-10-00: A Phase 2, Open-Label, Randomized, Multicenter Study of KYV101, an Autologous Fully Human Anti-CD19 Chimeric Antigen Receptor T Cell (CD19 CAR T) Therapy, in Subjects with Refractory Primary and Secondary Progressive Multiple Sclerosis (KYSA-7)
Protocol code: KYV101-007
Sponsor: Kyverna Therapeutics Inc. (Pharmaceutical company). Phase: Therapeutic exploratory (Phase II). Countries: Germany (authorised, recruitment pending), Italy (authorised, recruitment pending), Belgium (authorised, recruitment pending), Austria (authorised, recruitment pending).
Therapeutic area(s): Diseases [C] - Immune System Diseases [C20]; Diseases [C] - Nervous System Diseases [C10]
Gender: Female, Male. Age: 18-64 years. Enrolment: 88.
Status: Authorised, recruitment pending. Decision date: 2024-10-01. Results received: No. Last updated: 2026-08-03.
Decision dates by country: BE: 2024-10-02, IT: 2024-10-02, AT: 2024-10-07, DE: 2024-10-01

Condition(s): Primary or Secondary Progressive Multiple Sclerosis
Product: Briumvi 150 mg concentrate for solution for infusion, Ocrevus 300 mg concentrate for solution for infusion, Kesimpta 20 mg solution for injection in pre-filled syringe, Ocrevus 300 mg concentrate for solution for infusion, Kesimpta 20 mg solution for injection in pre-filled syringe, Ocrevus 300 mg concentrate for solution for infusion, Kesimpta 20 mg solution for injection in pre-filled syringe, Kesimpta 20 mg solution for injection in pre-filled pen, Kesimpta 20 mg solution for injection in pre-filled pen, MabThera 100 mg concentrate for solution for infusion, MabThera 500 mg concentrate for solution for infusion, KYV-101, Briumvi 150 mg concentrate for solution for infusion, MabThera 500 mg concentrate for solution for infusion, Briumvi 150 mg concentrate for solution for infusion, Ocrevus 300 mg concentrate for solution for infusion, Briumvi 150 mg concentrate for solution for infusion, Kesimpta 20 mg solution for injection in pre-filled syringe, Briumvi 150 mg concentrate for solution for infusion, Ocrevus 300 mg concentrate for solution for infusion, MabThera 500 mg concentrate for solution for infusion, Briumvi 150 mg concentrate for solution for infusion, Ocrevus 300 mg concentrate for solution for infusion, Kesimpta 20 mg solution for injection in pre-filled pen, Kesimpta 20 mg solution for injection in pre-filled syringe, Kesimpta 20 mg solution for injection in pre-filled pen, MabThera 500 mg concentrate for solution for infusion, Kesimpta 20 mg solution for injection in pre-filled syringe, Ocrevus 300 mg concentrate for solution for infusion, Kesimpta 20 mg solution for injection in pre-filled pen, Kesimpta 20 mg solution for injection in pre-filled pen, MabThera 100 mg concentrate for solution for infusion, Ocrevus 300 mg concentrate for solution for infusion, Kesimpta 20 mg solution for injection in pre-filled syringe, MabThera 100 mg concentrate for solution for infusion, Kesimpta 20 mg solution for injection in pre-filled pen, Kesimpta 20 mg solution for injection in pre-filled syringe, Kesimpta 20 mg solution for injection in pre-filled pen, Briumvi 150 mg concentrate for solution for infusion, Briumvi 150 mg concentrate for solution for infusion, MabThera 100 mg concentrate for solution for infusion

Primary endpoint: 1. Confirmed disability progression, defined as an increase in the EDSS
Endpoint(s): 2a. Incidence and severity of AEs, AESIs, and SAEs, 2b1. Composite Confirmed Disability Progression (CCPD) defined as disability progression measured by EDSS, 2b2. Impact on clinical disability as defined by the number of days from randomization to the primary outcome., 2b3. Disability as measured by EDSS change from pretreatment baseline to end of study., 2b4. Annualized relapse rate (ARR) in patients with active SPMS (relapse in the past 2 years or active lesions on MRI), 2b5. Comparison of end-of-study brain MRI compared to baseline scan in T2 burden of demyelinating disease, baseline to end of study, including whole brain volume and grey matter volume changes from treatment baseline to end of study., 2b6. For the CSF consenting subset, comparison of interval changes in unmatched intrathecal oligoclonal bands treatment from baseline to end of study., 2c. CAR-positive T-cell counts, CAR transgene level, B-cell counts over time, systemic cytokine concentrations., 2d. Presence of anti-KYV-101 antibodies.

Source: https://euclinicaltrials.eu/ctis-public/view/2024-511168-10-00